EU clinical trial 2024-515690-10-00: A PHASE I/II, MULTI-CENTER, OPEN-LABEL STUDY TO ASSESS THE SAFETY, PHARMACOKINETICS, AND PRELIMINARY EFFICACY OF AN ORALLY AVAILABLE SMALL MOLECULE, CC-99282, ALONE AND IN COMBINATION WITH ANTI-LYMPHOMA AGENTS IN SUBJECTS WITH RELAPSED OR REFRACTORY NON-HODGKIN LYMPHOMAS (R/R NHL)
Protocol code: CC-99282-NHL-001
Sponsor: Celgene Corp. (Pharmaceutical company). Phase: Phase I and Phase II (Integrated)- Other. Countries: Denmark (ongoing, recruiting), Spain (ongoing, recruitment ended), France (ongoing, recruitment ended), Italy (ongoing, recruitment ended).
Therapeutic area(s): Diseases [C] - Neoplasms [C04]
Gender: Female, Male. Age: 18-64 years, 65+ years. Enrolment: 204.
Start date (EU): 2019-05-10. Decision date: 2024-09-23. Results received: No. Last updated: 2026-07-10.
Decision dates by country: ES: 2024-09-27, FR: 2024-09-23, DK: 2024-09-23, IT: 2024-09-30

Condition(s): Diffuse large B-cell lymphoma, Mantle cell lymphoma, Follicular B-cell non-Hodgkin's lymphoma, Primary central nervous system lymphoma, Marginal zone lymphoma
Product: RITUXIMAB, RITUXIMAB, Golcadomide, Golcadomide, Valemetostat Tosylate, Golcadomide, Valemetostat Tosylate

Primary endpoint: AEs including treatment-emergent adverse events (TEAEs), laboratory assessments, vital signs, ECG results, ECOG performance status, LVEF assessments, and physical examinations., Recommended Phase 2 Dose (RP2D) and dosing Schedule(s): Dose limiting toxicities (DLTs), and Maximum Tolerated Dose (MTD) during the DLT evaluation period; establish the RP2D and optimal schedule of CC-99282 as monotherapy and in combination with rituximab obinutuzumab, tafasitamab or valemetostat ± rituximab.
Endpoint(s): Preliminary efficacy: Determined by the Lugano Classification for NHL response criteria including: Objective response rate (ORR), any complete response (CR) or partial response (PR) as best response; Time to response (TTR); Duration of response (DoR); Progression free survival (PFS) and overall survival (OS); Additional DOR, PFS and OS for subjects treated for 6 cycles with CC-99282 + rituximab who discontinue due to achieving CR (Cohort I), Preliminary efficacy in PCNSL: Determined using the modified International PCNSL Collaborative Group (IPCG) criteria including: Objective response rate (ORR); Time to response (TTR); Duration of response (DoR); Progression free survival (PFS) and overall survival (OS)

Source: https://euclinicaltrials.eu/ctis-public/view/2024-515690-10-00